EU clinical trial 2024-517589-41-00: A Study of YL201 in Patients With Advanced Solid Tumors
Protocol code: YL201-INT-101-01
Sponsor: Medilink Therapeutics (Suzhou) Co. Ltd. (Pharmaceutical company). Phase: Human Pharmacology (Phase I)- First administration to humans. Countries: France (authorised, recruiting), Spain (authorised, recruiting), Poland (authorised, recruiting).
Therapeutic area(s): Diseases [C] - Neoplasms [C04]
Gender: Female, Male. Age: 18-64 years, 65+ years. Enrolment: 115.
Status: Authorised, recruiting. Start date (EU): 2025-08-04. Decision date: 2025-07-07. Results received: No. Last updated: 2026-05-28.
Decision dates by country: ES: 2025-07-07, PL: 2025-07-09, FR: 2025-07-09

Condition(s): Advanced solid tumors

Source: https://euclinicaltrials.eu/ctis-public/view/2024-517589-41-00